EU clinical trial 2024-513359-34-00: The rimegePant in RElation to obeSiTy in mIGrainE study
Protocol code: PRESTIGE
Sponsor: Erasmus Universitair Medisch Centrum Rotterdam (Erasmus MC) (Hospital/Clinic/Other health care facility). Phase: Therapeutic use (Phase IV). Countries: Netherlands (ended).
Therapeutic area(s): Diseases [C] - Nervous System Diseases [C10]; Diseases [C] - Nutritional and Metabolic Diseases [C18]
Gender: Female, Male. Age: 18-64 years. Enrolment: 40.
Status: Ended. Start date (EU): 2025-03-10. End date (EU): 2025-11-13. Decision date: 2024-11-13. Results received: No. Last updated: 2025-01-21.

Condition(s): Obesity, Migraine
Product: RIMEGEPANT, Capsaicin

Primary endpoint: The inhibition of induced dermal blood flow (DBF) responses, before and after rimegepant administration, expressed as the difference in maximal DBF responses (ΔDBF) to capsaicin and electrical stimulation (ES), and stratified for body weight.
Endpoint(s): Blood: sex steroid levels, rimegepant concentration, CGRP, Body composition parameters: total body weight, total body water (TBW), free mass (FFM), fat mass (FM), soft lean mass (SLM), skeletal muscle mass (SMM), phase angle (PA), Similar outcome measures will be used as described for the primary objective, but stratified for sex steroids, rimegepant concentrations, CGRP and body composition parameters.

Source: https://euclinicaltrials.eu/ctis-public/view/2024-513359-34-00